EU clinical trial 2023-509691-41-00: Study to Assess the Effect of Food on the Pharmacokinetics of CA-4948 in Healthy Male Subjects
Protocol code: CA-4948
Sponsor: Curis Inc. (Pharmaceutical company). Phase: Human Pharmacology (Phase I)- Other. Countries: Netherlands (ended).
Therapeutic area(s): Diseases [C] - Hemic and Lymphatic Diseases [C15]
Gender: Male. Age: 18-64 years. Enrolment: 14.
Status: Ended. Start date (EU): 2024-03-14. End date (EU): 2024-05-11. Decision date: 2024-03-04. Results received: No. Last updated: 2024-03-04.

Condition(s): Hematologic malignancies

Source: https://euclinicaltrials.eu/ctis-public/view/2023-509691-41-00